EU clinical trial 2024-513023-17-00: EvAluation of the efficacy of MaaT013 as salvage theRapy in acute GVHD patiEntS with gastrointestinal involvement, refractory to ruxolitinib; a multi-center open-label phase III trial.
Protocol code: MPOH06
Sponsor: MaaT PHARMA (Pharmaceutical company). Phase: Therapeutic confirmatory (Phase III). Countries: Germany (ended), Belgium (ended), Italy (ended), France (ended), Austria (ended), Spain (ended).
Therapeutic area(s): Diseases [C] - Digestive System Diseases [C06]
Gender: Female, Male. Age: 18-64 years, 65+ years. Enrolment: 73.
Status: Ended. Start date (EU): 2022-01-12. End date (EU): 2025-09-24. Decision date: 2024-07-18. Results received: No. Last updated: 2025-02-24.
Decision dates by country: BE: 2024-07-19, FR: 2024-07-18, DE: 2024-07-22, IT: 2024-07-22, ES: 2024-07-22, AT: 2024-07-22

Condition(s): Treatment of acute graft-versus host disease (aGvHD) to the gastrointestinal (GI) tract of patients who are resistant or intolerant to ruxolitinib.
Product: MaaT013

Primary endpoint: To evaluate the efficacy of MaaT013 assessed by the overall response rate (ORR) of gastrointestinal (GI) acute grfat-versus-host disease (aGVHD) response at day 28 (D28).
Endpoint(s): To evaluate MaaT013 safety, To evalutae ORR for GI at D56 and M3, To evaluate ORR for all organs at D28, D56 and M3, To evaluate the best ORR (for GI and all organs) acheived between D0 and D28, To assess duration of response, To assess overall survival (OS), To assess progression-free survival (PFS), To assess time to progression, To assess steroid-free survival, To evaluate the frequency of patients that tapered off CS, To measure the incidence of chronic GvHD, To evaluate changes in patient reported outcomes (PROs)

Source: https://euclinicaltrials.eu/ctis-public/view/2024-513023-17-00